EU clinical trial 2024-514780-26-00: SARCOME 13 / OS2016 - A Multicentre, Randomised, Open-label, Phase 2 trial of mifamurtide combined with post-operative chemotherapy for newly diagnosed high risk osteosarcoma patients (metastatic osteosarcoma at diagnosis or localised disease with poor histological response)
Protocol code: UC-0150/1704
Sponsor: Unicancer (Hospital/Clinic/Other health care facility). Phase: Therapeutic exploratory (Phase II). Countries: France (ongoing, recruiting).
Therapeutic area(s): Diseases [C] - Neoplasms [C04]
Gender: Female, Male. Age: 0-17 years, 18-64 years. Enrolment: 315.
Status: Ongoing, recruiting. Start date (EU): 2018-10-23. Decision date: 2024-07-10. Results received: No. Last updated: 2024-07-10.

Condition(s): Patients ≤50 years old with high-risk osteosarcoma (defined as metastatic osteosarcoma at diagnosis or localised osteosarcoma with poor histological response) after pre-operative chemotherapy and surgery of the primary tumour and lung metastases (if applicable).
Product: DOXORUBICIN HYDROCHLORIDE, IFOSFAMIDE, CISPLATIN, METHOTREXATE, ETOPOSIDE, MEPACT 4 mg powder for concentrate for dispersion for infusion

Primary endpoint: Event-free survival (EFS) estimated from the randomisation date to the time of first event (loco-regional or distant relapse or progression, second malignancy, death from any cause). Observations will be censored at the date of last follow-up visit for the patients remaining in first complete remission.
Endpoint(s): Overall survival (OS) from the randomisation date to the date of death, whatever the cause of death., Progression Free-survival (PFS) from the randomisation date to the date of disease progression (radiological or clinical) or death of any cause, whichever occurs first. Observations will be censored at the date of last follow-up visit for the patients remaining in first complete remission., Feasibility of the planned treatment with calculation of cumulative dose and dose intensity of mifamurtide and chemotherapy, Safety : all adverse events (NCI-CTCAE v5) will be analysed except AE unequivocally related to the underlying disease or its progression/relapse., Long-term toxicity, Biomarkers to evaluate mifamurtide mechanisms of action and resistance

Source: https://euclinicaltrials.eu/ctis-public/view/2024-514780-26-00